EU clinical trial 2023-506795-27-00: Effect of dimethyl fumarate administered to patients with adrenomyeloneuropathy: a multicenter, placebo controlled, phase IIb/III trial
Sponsor: Fundacio Institut D Investigacio Biomedica De Bellvitge IDIBELL (Laboratory/Research/Testing facility). Phase: Phase II and Phase III (Integrated). Countries: Spain (ongoing, recruitment ended).
Therapeutic area(s): Diseases [C] - Nervous System Diseases [C10]
Gender: Female, Male. Age: 18-64 years. Enrolment: 40.
Status: Ongoing, recruitment ended. Start date (EU): 2024-04-15. Decision date: 2024-01-31. Results received: No. Last updated: 2025-02-14.

Condition(s): Adrenomyeloneuropathy
Product: Skilarence 120 mg gastro-resistant tablets, MAGNESIUM STEARATE, MICROCRYSTALLINE CELLULOSE

Primary endpoint: The primary endpoint is the mean change in 2 Minute Walk Test (2MWT) between M0 and M24. This criterion will also be evaluated at M6, M12 and at the end of the extension phase (M36). Details about the 2MWT are given in chapter 3.7.
Endpoint(s): Secondary efficacy endpoints will be evaluated by the 6 Minute Walk Test (6MWT), the Time to walk 25 feet (TW25), the Postural Sway, the stair-climbing test, the strength, one questionnaire about urinary tract function (SF-Qualiveen), one questionnaire to assess fecal incontinence (RFIS), neuroimaging and biological markers. Details are given in chapter 3.7., Mean changes in 6MWT, TW25 between M0 and M24. Evaluation will also be done at M6, M12 and M36., Mean changes in postural sway, stair-climbing test, and strength between M-1 and M24. Evaluation will also be done at M12 and M36., Mean changes in the SF-Qualiveen and RFIS between M0 and M24. Evaluation will also be done at M12 and M36., Mean changes in Loes score, diffusion tensor imaging (DTI), and magnetic resonance spectroscopy (MRS) parameters in the cerebral white matter on M-1 and M24. Evaluation will also be done at M12 and M36., Mean changes in markers of target-engagement (oxidative damage and inflammation) between M-1 and M24. Evaluation will also be done at M3 and M12., Markers of neuroaxonal damage and astrocyte activation: • Mean changes in NfL and GFAP in plasma at M-1, M3, M12, and M24, and in CSF at M0 and M24., Very long-chain fatty acid (VLCFA) levels • Mean changes in C26:0 and C24:0 in plasma and CSF at M-1, and M24., Single cell RNA sequencing (scRNAseq) of PBMC • Comparison of scRNAseq data from n=5 AMN patients (group 1: placebo), and n=10 from AMN (group 2: DMF), plus 10 samples from of age and sex-matched control adults at M-1 and M3., Lipidomics • Analysis of glycerolipids, glycerophospholipids, and sphingolipids at M-1, M3, M12 and M24 in plasma., Metabolomics • Analysis of metabolomics in stools at M-1, and M6., Metagenomics • Identification in stools of the different taxa, and enzymes affected by the treatment with DMF at M-1 and M6.

Source: https://euclinicaltrials.eu/ctis-public/view/2023-506795-27-00